EU clinical trial 2023-508962-14-00: A Phase III, Open-Label, Randomized Study to Evaluate the Efficacy and Safety of Single Agent Belantamab Mafodotin Compared to Pomalidomide plus Low-dose Dexamethasone (pom/dex) in Participants with Relapsed/Refractory Multiple Myeloma (RRMM) (DREAMM 3)
Protocol code: 207495
Sponsor: Glaxosmithkline Research & Development Limited (Pharmaceutical company). Phase: Therapeutic confirmatory (Phase III). Countries: Hungary (ended), Italy (ended), Netherlands (ended), Poland (ended), Spain (ended), France (ongoing, recruitment ended), Belgium (ended), Germany (ended), Bulgaria (ongoing, recruitment ended), Greece (ongoing, recruitment ended).
Therapeutic area(s): Diseases [C] - Neoplasms [C04]
Gender: Female, Male. Age: 18-64 years, 65+ years. Enrolment: 141.
Start date (EU): 2020-06-18. Decision date: 2024-06-05. Results received: No. Last updated: 2025-10-28.
Decision dates by country: DE: 2024-06-11, ES: 2024-06-06, PL: 2024-06-17, IT: 2024-06-10, HU: 2024-06-05, BE: 2024-06-05, NL: 2024-06-07, GR: 2024-07-22, FR: 2024-06-05, BG: 2024-06-14

Condition(s): Relapsed/Refractory Multiple Myeloma
Product: Dexamethason 8 mg GALEN® Tabletten, Imnovid 1 mg hard capsules, Dexamethasone 2mg Tablets, Dexamethason 8 mg JENAPHARM®, Dexamethasone Tablets BP 2.0mg, Imnovid 4 mg hard capsules

Primary endpoint: PFS, defined as the time from the date of randomization until the earliest date of documented disease progression (according to IMWG Response Criteria) or death due to any cause
Endpoint(s): OS, defined as the time from randomization until death due to any cause, ORR, defined as the percentage of participants with a confirmed PR or better per IMWG, Clinical benefit rate (CBR), defined as the percentage of participants with a confirmed Minimal response (MR) or better per IMWG, DoR, defined as the time from first documented evidence of PR or better until PD per IMWG or death due To any cause among participants who achieve confirmed PR or better, TTR, defined as the time between the date of randomization and the first documented evidence of response (PR or better) among participants who achieve confirmed PR or better, TTP, defined as the time from the date of randomization until the earliest date of documented PD (per IMWG response Criteria) or death due To PD, Incidence of adverse events (AEs) and changes in laboratory parameters, Ocular findings on ophthalmic exam, Plasma concentrations of belantamab mafodotin, total mAb, and cys-mcMMAF, Incidence and titers of ADAs against belantamab mafodotin, Symptomatic adverse effects as measured by the PRO-CTCAE and OSDI, Health-related QOL as measured by EORTC QLQ-C30, EORTC IL52* and EORTC QLQ-MY20*, MRD negativity rate, defined as; the percentage of participants who are MRD negative by NGS method

Source: https://euclinicaltrials.eu/ctis-public/view/2023-508962-14-00